EU clinical trial 2024-515058-26-00: Early rituximab treatment in children with idiopathic nephrotic syndrome Eng. ERICONS - Early RITUXIMAB in Childhood Onset Nephrotic Syndrome
Protocol code: NBK155/1/2020
Sponsor: Medical University Of Gdansk (Educational Institution). Phase: Therapeutic confirmatory (Phase III). Countries: Poland (ongoing, recruiting).
Therapeutic area(s): Diseases [C] - Pathological Conditions, Signs and Symptoms [C23]
Gender: Female, Male. Age: 0-17 years. Enrolment: 60.
Status: Ongoing, recruiting. Start date (EU): 2021-12-17. Decision date: 2024-11-07. Results received: No. Last updated: 2025-11-14.

Condition(s): NEPHROTIC SYNDROME
Product: MabThera 100 mg concentrate for solution for infusion, Saline

Primary endpoint: Relapse-free survival (defined as the occurrence of proteinuria persisting for ≥ 3 days during the blinded phase (from day 1 to day 365)).
Endpoint(s): Time to treatment failure 1a. Percentage of failures in the experimental and placebo groups., Total dose of administered steroids., Time from depletion resolution to relapse., Relapse-free survival during the open-label phase (from the day of investigational drug administration to day 365 of observation).

Source: https://euclinicaltrials.eu/ctis-public/view/2024-515058-26-00